EU clinical trial 2024-511213-38-00: A Phase 2a/b, randomized, double blind, placebo controlled, parallel group study to investigate the efficacy and safety of subcutaneous amlitelimab in adult patients with non responsive celiac disease as an adjunct to a gluten free diet
Protocol code: DRI17963
Sponsor: Sanofi-Aventis Recherche & Developpement (Pharmaceutical company). Phase: Therapeutic exploratory (Phase II). Countries: Finland (ongoing, recruitment ended), Slovakia (ongoing, recruitment ended), France (ongoing, recruitment ended), Sweden (ongoing, recruitment ended), Germany (ongoing, recruitment ended), Netherlands (ongoing, recruitment ended), Greece (ongoing, recruitment ended), Italy (ongoing, recruitment ended), Poland (ongoing, recruitment ended), Belgium (ongoing, recruitment ended), Czechia (ongoing, recruitment ended), Spain (ongoing, recruitment ended).
Therapeutic area(s): Diseases [C] - Digestive System Diseases [C06]
Gender: Female, Male. Age: 18-64 years, 65+ years. Enrolment: 374.
Status: Ongoing, recruitment ended. Start date (EU): 2024-10-15. Decision date: 2024-09-02. Results received: No. Last updated: 2026-07-14.
Decision dates by country: GR: 2024-09-09, BE: 2024-09-09, IT: 2024-09-04, PL: 2024-09-06, FI: 2024-09-04, CZ: 2024-09-05, ES: 2024-09-09, DE: 2024-09-06, FR: 2024-09-03, SE: 2024-09-05, NL: 2024-11-21, SK: 2024-09-02

Condition(s): Coeliac disease
Product: Amlitelimab matching placebo to test product, Amlitelimab

Primary endpoint: Change in Villus Height to Crypt Depth Ratio (Vh:Cd) from baseline to Week 28
Endpoint(s): Change in Celiac Disease Symptom Diary (CDSD) Gastrointestinal (GI) symptom severity score, Percentage of participants who experienced treatment-emergent adverse events (TEAEs), including serious adverse events (SAEs) and adverse events of special interest (AESI) during the placebo-controlled treatment period and the long-term extension, Percentage of participants with potentially clinically significant abnormalities (PCSA) for vital signs and clinical laboratory assessments during the placebo-controlled treatment period and the long-term extension, Percentage of participants discontinued from study treatment due to TEAEs during the placebo-controlled treatment period and the long-term extension, Serum amlitelimab concentrations measured at prespecified timepoints, Incidence of anti-drug antibodies (ADAs) of amlitelimab

Source: https://euclinicaltrials.eu/ctis-public/view/2024-511213-38-00